EU clinical trial 2023-503709-12-00: Open-label pilot study to assess the efficacy and safety of Cannabidiol oral solution as an adjunctive treatment for children and young adults with rare disease-associated severe epilepsy
Protocol code: CBD_RE
Sponsor: Azienda Ospedaliero Universitaria Meyer IRCCS (Hospital/Clinic/Other health care facility). Phase: Therapeutic exploratory (Phase II). Countries: Italy (ongoing, recruitment ended).
Therapeutic area(s): Diseases [C] - Nervous System Diseases [C10]
Gender: Female, Male. Age: 0-17 years, 18-64 years. Enrolment: 30.
Status: Ongoing, recruitment ended. Start date (EU): 2024-04-12. Decision date: 2023-06-23. Results received: No. Last updated: 2026-01-14.

Condition(s): Epilepsy
Product: Epidyolex 100 mg/ml oral solution

Primary endpoint: Assess the percentage change per 28 days from the 4-week baseline period in generalized and/or focal motor-onset seizure frequency during the 24-week treatment period;, Assess EEG improvement from baseline during treatment period in a blind senior epileptologists evaluation procedure; a score will be established for each patient, based on review and comparison of all baseline-EEG/7-weeks control-EEG and baseline-EEG/15-weeks control-EEG, with values ranging from 0 (= worsened EEG), to a maximum of 2 (= improved); 1 will be assigned if the EEG trace is unmodified
Endpoint(s): Assess the safety and tolerability of CBD as an adjunctive therapy based on safety variables (adverse events, vital signs, body weight, physical examination, neurological examination), Assess pharmacokinetic interaction with concurrent ASMs (blood levels of concurrent ASMs will be taken at baseline and every 4 weeks);, Assess the number of subjects considered treatment responders, defined as those with a ≥25%, ≥50% ≥75% reduction in motor (generalized, focal, or both) seizures from baseline;, Assess the number of subjects who are free of motor (generalized, focal, or both) seizures;, Assess the longest period of seizure freedom;, Assess the number of patients experiencing a >25% worsening, −25 to +25% no change, 25–50% improvement, 50–75% improvement or >75% improvement in total seizures from baseline;, Assess changes from baseline in number of inpatient hospitalizations due to epilepsy (6 months-period);, Assess change in severity of seizures will be assessed using a pediatric adaptation of the Chalfont Seizure Severity Scale (Duncan & Sander, 1991);, Assess the change from baseline to 6-months after treatment initiation in number of seizure-free days;, Assess the changes from baseline to week 24 in the following scores: cognitive, adaptative, behavioural, functional, quality of life, caregivers and investigator impressions on global severity and improvement, sleep habits.

Source: https://euclinicaltrials.eu/ctis-public/view/2023-503709-12-00